EU clinical trial 2025-522116-16-00: Phase IV multicenter immunogenicity and safety study of the Seqirus licensed zoonotic influenza vaccine (H5N8) in adults immunized with an H5N1/MF59 influenza vaccine, approximately 20 years before the trial, compared to H5 naive adult participants.
Protocol code: FLU-SEQ
Sponsor: University Of Antwerp (Educational Institution). Phase: Therapeutic use (Phase IV). Countries: Italy (ended), Belgium (ended).
Therapeutic area(s): Diseases [C] - Virus Diseases [C02]
Gender: Female, Male. Age: 18-64 years, 65+ years. Enrolment: 60.
Status: Ended. Start date (EU): 2025-12-08. End date (EU): 2026-04-09. Decision date: 2025-10-06. Results received: No. Last updated: 2025-10-16.
Decision dates by country: BE: 2025-10-06, IT: 2025-10-16

Condition(s): Avian Influenza
Product: Zoonotic Influenza Vaccine Seqirus suspension for injection in pre-filled syringe Zoonotic influenza vaccine (H5N8) (surface antigen, inactivated, adjuvanted)

Primary endpoint: HI antibody titers against the vaccine virus strain (H5N8 clade 2.3.4.4b) at baseline (Day 0) and 28 days after the first dose, and 28 days after the second dose (Day 56), MN antibody titers against the vaccine virus strain (H5N8 clade 2.3.4.4b) at baseline (Day 0), 28 days after the first dose, and 28 days after the second dose (Day 56)
Endpoint(s): HI antibody titers against the vaccine virus strain (H5N8 clade 2.3.4.4b) 7 days after the first dose, and 7 days after the second dose (Day 35), Fold increase in HI antibody titers against the virus strain (H5N8 clade 2.3.4.4b) 7 days and 28 days after the first dose, and 7 days and 28 days after the second dose (Day 35, Day 56), compared to baseline (Day 0), Serodetection, based on HI antibody titers against the virus strain (H5N8 clade 2.3.4.4b) at baseline (Day 0), 7 days and 28 days after the first dose, and 7 days and 28 days after the second dose (Day 35, Day 56), Seroconversion, based on HI antibody titers against the virus strain (H5N8 clade 2.3.4.4b) 7 days and 28 days after the first dose, and 7 days and 28 days after the second dose (Day 35, Day 56), compared to baseline (Day 0), Seroprotection, based on HI antibody titers against the virus strain (H5N8 clade 2.3.4.4b) at baseline (Day 0), 7 days and 28 days after the first dose, and 7 days and 28 days after the second dose (Day 35, Day 56), MN antibody titers against the vaccine virus strain (H5N8 clade 2.3.4.4b) 7 days after the first dose, and 7 days after the second dose (Day 35), HI antibody titers against heterologous virus strains (including but not limited to H5N1 clade 1 A/Vietnam/1194/2004 and H5N1 clade 2.2.1 A/turkey/Turkey/1/2005) at baseline (Day 0), 7 days and 28 days after the first dose, and 7 days and 28 days after the second dose (Day 35, Day 56), Fold increase in HI antibody titers against heterologous virus strains (including but not limited to H5N1 clade 1 A/Vietnam/1194/2004 and H5N1 clade 2.2.1 A/turkey/Turkey/1/2005) 7 days and 28 days after the first dose, and 7 days and 28 days after the second dose (Day 56), compared to baseline (Day 0), Serodetection, based on HI antibody titers against heterologous virus strains (including but not limited to H5N1 clade 1 A/Vietnam/1194/2004 and H5N1 clade 2.2.1 A/turkey/Turkey/1/2005) at baseline (Day 0), 7 days and 28 days after the first dose, and 7 days and 28 days after the second dose (Day 35, Day 56), Seroconversion, based on HI antibody titers against heterologous virus strains (including but not limited to H5N1 clade 1 A/Vietnam/1194/2004 and H5N1 clade 2.2.1 A/turkey/Turkey/1/2005) 7 days and 28 days after the first dose, and 7 days and 28 days after the second dose (Day 35, Day 56), compared to baseline (Day 0), Seroprotection, based on HI antibody titers against heterologous virus strains (including but not limited to H5N1 clade 1 A/Vietnam/1194/2004 and H5N1 clade 2.2.1 A/turkey/Turkey/1/2005) at baseline (Day 0), 7 days and 28 days after the first dose, and 7 days and 28 days after the second dose (Day 35, Day56), MN antibody titers against heterologous virus strains (including but not limited to H5N1 clade 1 A/Vietnam/1194/2004 and H5N1 clade 2.2.1 A/turkey/Turkey/1/2005) at baseline (Day 0), 7 days and 28 days after the first dose, and 7 days and 28 days after the second dose (Day 35, Day 56), Occurrence of all SAEs from the day of vaccination up to the study end, Occurrence of all SAEs related to study intervention from the day of vaccination up to the study end

Source: https://euclinicaltrials.eu/ctis-public/view/2025-522116-16-00